EU clinical trial 2025-523861-58-00: A clinical study of MK-6050 in healthy people (MK-6050-001)
Protocol code: MK-6050-001
Sponsor: Merck Sharp & Dohme LLC (Pharmaceutical company). Phase: Human Pharmacology (Phase I)- First administration to humans. Countries: Belgium (ended).
Therapeutic area(s): Diseases [C] - Immune System Diseases [C20]
Gender: Male. Age: 18-64 years. Enrolment: 32.
Status: Ended. Start date (EU): 2025-11-24. End date (EU): 2026-04-02. End date: 2026-04-03. Decision date: 2025-11-12. Results received: No. Last updated: 2025-12-05.

Condition(s): Hidradenitis suppurativa

Source: https://euclinicaltrials.eu/ctis-public/view/2025-523861-58-00